EU clinical trial 2025-522273-10-00: A study to investigate safety, tolerability, pharmacokinetics, and pharmacodynamics of surovatamig in adult participants with rheumatoid arthritis or systemic lupus erythematosus.
Protocol code: D740AC00001
Sponsor: AstraZeneca AB (Pharmaceutical company). Phase: Human Pharmacology (Phase I)- Other. Countries: Germany (ongoing, recruiting), Spain (authorised, recruiting), Belgium (authorised, recruiting).
Therapeutic area(s): Diseases [C] - Immune System Diseases [C20]; Diseases [C] - Musculoskeletal Diseases [C05]
Gender: Female, Male. Age: 18-64 years. Enrolment: 15.
Start date (EU): 2026-02-24. Decision date: 2026-02-03. Results received: No. Last updated: 2026-07-17.
Decision dates by country: ES: 2026-02-06, BE: 2026-02-09, DE: 2026-02-03

Condition(s): Rheumatoid Arthritis, Systemic Lupus Erythematosus

Source: https://euclinicaltrials.eu/ctis-public/view/2025-522273-10-00